EU clinical trial 2025-524337-11-00: A Phase 3, Randomized, Open-label, Multicenter Study to Compare the Efficacy and Safety of BMS-986353, CD19-targeted NEX-T CAR T Cells, Versus Standard of Care in Participants with Active Systemic Sclerosis (Breakfree-SSc)
Protocol code: CA0611005
Sponsor: Celgene Corp. (Pharmaceutical company). Phase: Therapeutic confirmatory (Phase III). Countries: Spain (authorised, recruitment pending), Germany (authorised, recruitment pending), France (authorised, recruitment pending), Italy (authorised, recruitment pending).
Therapeutic area(s): Diseases [C] - Immune System Diseases [C20]
Gender: Female, Male. Age: 0-17 years, 18-64 years, 65+ years. Enrolment: 33.
Status: Authorised, recruitment pending. Decision date: 2026-06-19. Results received: No. Last updated: 2026-06-22.
Decision dates by country: FR: 2026-06-22, DE: 2026-06-19, IT: 2026-06-22, ES: 2026-06-22

Condition(s): Systemic Sclerosis
Product: NINTEDANIB, FLUDARABINE PHOSPHATE, TOCILIZUMAB, CYCLOPHOSPHAMIDE, TOCILIZUMAB, NINTEDANIB, CD19-Targeted NEX-T CAR T, RITUXIMAB

Primary endpoint: How much the amount of air a person can blow out of their lungs (called Forced Vital Capacity, or FVC) changes. This is measured in milliliters (mL).
Endpoint(s): How much the skin thickness (measured by the Modified Rodnan Skin Score, or mRSS) changes., Changes in lung function (FVC in mL) or in skin thickness (mRSS)., Changes in the percentage of predicted FVC (ppFVC), which compares a person’s lung function to what is expected for someone their age and size., Changes in how well the lungs transfer oxygen (called DLCO)., How long it takes for the disease to get worse, starting from when a person joins the study.

Source: https://euclinicaltrials.eu/ctis-public/view/2025-524337-11-00